EU clinical trial 2024-514602-31-00: Long-term aspirin therapy as a predictor of decreased susceptibility to SARSCoV-2 infection in aspirin-exacerbated respiratory disease
Protocol code: AERD-COV19
Sponsor: Uniwersytet Jagiellonski Collegium Medicum (Educational Institution). Phase: Phase II and Phase III (Integrated). Countries: Poland (ended).
Therapeutic area(s): Diseases [C] - Respiratory Tract Diseases [C08]
Gender: Female, Male. Age: 18-64 years, 65+ years. Enrolment: 76.
Status: Ended. Start date (EU): 2022-12-07. End date (EU): 2025-01-23. Decision date: 2024-07-01. Results received: Yes. Last updated: 2024-07-01.

Condition(s): aspirin-exacerbated respiratory disease
Product: ACARD 300 mg, 300 mg, tabletki, Microcrystalline cellulose, Native corn starch, Citric acid anhydrous (E330)

Primary endpoint: whether aspirin desensitization followed by long-term high-dose aspirin therapy in patients with AERD associated with lower gene expression of ACE2, TMPRSS2, BSG, PPIA, PPIB, DPP4, IFNA1, IFNB1 IFNG, IFNL1 i IFNL2 and ISG in sputum and nasal cells.
Endpoint(s): Whether the change of gene expression during aspirin therapy is connected with lower risk of SARS-CoV-2 infection

Source: https://euclinicaltrials.eu/ctis-public/view/2024-514602-31-00